EU clinical trial 2025-521384-12-00: A research study to compare blood levels of cagrilintide after multiple doses of different versions of cagrilintide in adults with overweight or obesity
Protocol code: NN9833-8285
Sponsor: Novo Nordisk A/S (Pharmaceutical company). Phase: Human Pharmacology (Phase I)- Bioequivalence Study. Countries: Germany (ongoing, recruiting).
Therapeutic area(s): Diseases [C] - Nutritional and Metabolic Diseases [C18]
Gender: Female, Male. Age: 18-64 years. Enrolment: 234.
Status: Ongoing, recruiting. Start date (EU): 2026-04-27. Decision date: 2026-04-21. Results received: No. Last updated: 2026-06-02.
Decision dates by country: DE: 2026-06-02

Condition(s): obesity

Source: https://euclinicaltrials.eu/ctis-public/view/2025-521384-12-00